EU clinical trial 2025-524871-22-00: Study to assess the relative bioavailability of Neludolat versus YAZ in healthy female subjects.
Protocol code: PEV-ETH/DRO-2025
Sponsor: Pevisal Group Farmaceutici S.r.l. (Laboratory/Research/Testing facility). Phase: Human Pharmacology (Phase I)- Bioequivalence Study. Countries: Czechia (ended).
Therapeutic area(s): Phenomena and Processes [G] - Reproductive and Urinary Physiological Phenomena [G08]
Gender: Female. Age: 18-64 years. Enrolment: 24.
Status: Ended. Start date (EU): 2026-07-07. End date (EU): 2026-08-04. Decision date: 2026-06-12. Results received: No. Last updated: 2026-06-12.

Condition(s): Healthy subjects

Source: https://euclinicaltrials.eu/ctis-public/view/2025-524871-22-00